EU clinical trial 2023-503970-19-00: Randomised, crossover bioequivalence clinical trial of apixabán 5 mg film coated tablets, after a single oral dose administration to healthy volunteers under fasting conditions.
Protocol code: N-API-23-276
Sponsor: Laboratorios Normon S.A. (Pharmaceutical company). Phase: Human Pharmacology (Phase I)- Bioequivalence Study. Countries: Spain (ended).
Therapeutic area(s): Not possible to specify
Gender: Female, Male. Age: 18-64 years. Enrolment: 24.
Status: Ended. Start date (EU): 2023-03-31. End date (EU): 2023-04-28. Decision date: 2023-03-27. Results received: Yes. Last updated: 2023-03-27.

Condition(s): Healthy volunteers
Product: Eliquis 5 mg film-coated tablets, Apixabán Normon 5 mg comprimidos recubiertos con película

Primary endpoint: AUC0-t, Cmax
Endpoint(s): AUC0-∞, Tmax

Source: https://euclinicaltrials.eu/ctis-public/view/2023-503970-19-00